EU clinical trial 2023-507060-39-00: A phase 1 study of GSK2857916 + Standard of Care (SOC) in first line multiple myeloma patients (DREAMM-9)
Protocol code: 209664
Sponsor: Glaxosmithkline Research & Development Limited (Pharmaceutical company). Phase: Human Pharmacology (Phase I)- Other. Countries: France (ended), Italy (ended), Germany (authorised, recruitment pending), Poland (ongoing, recruitment ended), Spain (ended).
Therapeutic area(s): Diseases [C] - Neoplasms [C04]
Gender: Female, Male. Age: 18-64 years, 65+ years. Enrolment: 67.
Start date (EU): 2020-03-04. Decision date: 2024-02-26. Results received: No. Last updated: 2025-10-07.
Decision dates by country: IT: 2024-02-26, ES: 2024-02-26, FR: 2024-02-27, DE: 2024-02-27, PL: 2024-02-26

Condition(s): Multiple Myeloma

Source: https://euclinicaltrials.eu/ctis-public/view/2023-507060-39-00